EU clinical trial 2023-503734-47-00: A single and multiple ascending dose study to investigate the safety, tolerability, pharmacokinetics, and pharmacodynamics of AZP-3813, a growth hormone antagonist, in healthy subjects
Protocol code: AZP-3813-CLI-001
Sponsor: Amolyt Pharma (Pharmaceutical company). Phase: Human Pharmacology (Phase I)- First administration to humans. Countries: Netherlands (ended).
Therapeutic area(s): Diseases [C] - Hormonal diseases [C19]
Gender: Female, Male. Age: 18-64 years, 65+ years. Enrolment: 101.
Status: Ended. Start date (EU): 2023-05-26. End date (EU): 2024-04-23. Decision date: 2023-04-24. Results received: No. Last updated: 2023-12-22.

Condition(s): Acromegaly

Source: https://euclinicaltrials.eu/ctis-public/view/2023-503734-47-00